EU clinical trial 2023-510187-13-00: Efficacy of solifenacin, mirabegron and combination therapy in children with overactive bladder and daytime urinary incontinence (BeDry)
Protocol code: BeDry-2023
Sponsor: Region Midtjylland (Hospital/Clinic/Other health care facility). Phase: Therapeutic confirmatory (Phase III). Countries: Denmark (ongoing, recruiting).
Therapeutic area(s): Diseases [C] - Female Urogenital Diseases and Pregnancy Complications [C13]; Diseases [C] - Male Urogenital Diseases [C12]
Gender: Female, Male. Age: 0-17 years. Enrolment: 236.
Status: Ongoing, recruiting. Start date (EU): 2024-06-27. Decision date: 2024-04-19. Results received: No. Last updated: 2024-06-12.

Condition(s): Daytime urinary incontinence and overactive bladder
Product: Betmiga 25 mg prolonged-release tablets, Solifenacin "Krka", filmovertrukne tabletter

Primary endpoint: The primary outcome measure is treatment response as defined by non-response (<50% decrease in number of wet days) and response (50-100% decrease in number of wet days), assessed by a change from visit 2 and across the 12-week pharmacological treatment period. The number of wet days is assessed pr. 7 days by DryPie. The treatment response will be evaluated for solifenacin, mirabegron and combination of solifenacin and mirabegron.
Endpoint(s): Change in number of wet days pr. 7 days assessed by Dry Pie, baseline to 18 weeks, Change in incontinence severity score pr. 7 days assessed by Dry Pie, baseline to 18 weeks, Change in urge severity quantified by Bower VAS Urgency, baseline to 18 weeks, Change in maximum volume voided (MVV), baseline to 18 weeks, Change in age standardized MVV (MVV as a percent of expected bladder capacity (EBC)), baseline to 18 weeks, Change in average voided volume (AVV), baseline to 18 weeks, Change in micturition frequency, baseline to 18 weeks, Change in fluid-intake, baseline to 18 weeks, Change in maximum flow rate (Qmax) assessed by uroflowmetry, baseline to 18 weeks, Change in Pediatric incontinence questionnaire total score, baseline to 18 weeks, Change in WHO-5 total score, baseline to 18 weeks, Adverse event (AE), serious adverse event (SAE) and Suspected Unexpected Serious Adverse Reaction (SUSAR) monitoring, Change in blood pressure and pulse, baseline to 18 weeks, Change in ultrasonic assessed post-void residual urine, baseline to 18 weeks, Identifications of ECG abnormalities by electrocardiogram, Identification of urinary tract infection by urine dipstick and verified by routine urine cultivation, Treatment response of solifenacin, mirabegron and combination of solifenacin and mirabegron, baseline across 18 week treatment period

Source: https://euclinicaltrials.eu/ctis-public/view/2023-510187-13-00